EU clinical trial 2024-515332-80-00: A Phase III, randomized, open label, non-inferiority study comparing the efficacy and safety of furazidin vaginal tablets and clindamycin vaginal cream in the local treatment of bacterial vaginosis
Protocol code: FUR-05-24
Sponsor: Adamed Pharma S.A. (Pharmaceutical company). Phase: Therapeutic confirmatory (Phase III). Countries: Italy (authorised, recruiting), Czechia (ongoing, recruiting), Poland (ongoing, recruiting), Slovakia (ongoing, recruiting).
Therapeutic area(s): Diseases [C] - Bacterial Infections and Mycoses [C01]
Gender: Female. Age: 18-64 years. Enrolment: 600.
Start date (EU): 2026-02-23. Decision date: 2025-12-01. Results received: No. Last updated: 2026-04-27.
Decision dates by country: SK: 2025-12-01, CZ: 2025-12-02, IT: 2025-12-05, PL: 2025-12-08

Condition(s): Bacterial vaginosis
Product: Furazidin, vaginal tablets, 5mg, Dalacin 20 mg/g hüvelykrém

Primary endpoint: Clinical cure rate at Visit 3 (test of cure, Day 8-10), based on Amsel criteria. Clinical cure is defined as the resolution of the abnormal vaginal discharge, a negative whiff test, and the presence of clue cells at less than 20% of the total epithelial cells on microscopic examination of the saline wet mount.
Endpoint(s): Percentage of participants with Nugent score ranging from 0 to 3 (Visit 4, Day 21-30)., Percentage of participants who achieved clinical cure at Visit 3 (Test of cure, Day 8-10) and had a Nugent score ranging from 0 to 3 (Visit 4, Day 21-30)., Incidence of adverse events (AEs) and serious adverse events (SAEs), both related and unrelated to the investigational medicinal product (IMP)., Percentage of Bacterial Vaginosis recurrences within 12 weeks of follow-up (assessed with Amsel criteria) in participants who achieved clinical cure status at Visit 3 (Day 8-10)., Assessment of participants’ quality of life based on VAS scale from the baseline visit to the end of the observation (Visit 5, at least in 13 or 14 week after end of treatment).

Source: https://euclinicaltrials.eu/ctis-public/view/2024-515332-80-00